EU clinical trial 2023-506575-99-00: Finding the Optimal Regimen for Mycobacterium abscessus Treatment
Protocol code: FORMaT001
Sponsor: The University Of Queensland (Educational Institution). Phase: Therapeutic exploratory (Phase II). Countries: Denmark (ongoing, recruiting).
Therapeutic area(s): Diseases [C] - Respiratory Tract Diseases [C08]; Diseases [C] - Bacterial Infections and Mycoses [C01]
Gender: Female, Male. Age: 18-64 years, 65+ years. Enrolment: 20.
Status: Ongoing, recruiting. Start date (EU): 2023-01-02. Decision date: 2023-07-21. Results received: No. Last updated: 2025-10-13.

Condition(s): Mycobacterium abscessus pulmonary disease
Product: LINEZOLID, DOXYCYCLINE, CEFOXITIN, CLARITHROMYCIN, CEFOXITIN, MOXIFLOXACIN, AMIKACIN, IMIPENEM, DOXYCYCLINE, CLOFAZIMINE, RIFABUTIN, CILASTATIN, TRIMETHOPRIM, AZITHROMYCIN, CLARITHROMYCIN, TIGECYCLINE, CLOFAZIMINE, CLARITHROMYCIN, ETHAMBUTOL, SULFAMETHOXAZOLE, BEDAQUILINE, ETHAMBUTOL, CLARITHROMYCIN, AZITHROMYCIN, DOXYCYCLINE, AMIKACIN, AZITHROMYCIN

Primary endpoint: Negative MABS cultures from four consecutive sputum samples with one of those sputum specimens collected four weeks after the completion of consolidation therapy, or a MABS negative Bronchoalveolar Lavage (BAL) collected four weeks after completion of consolidation., “Good” tolerance is defined as no adverse events occurring or only adverse events coded as CTCAE grades 1 and 2. “Poor” tolerance is defined as any adverse events attributed as possibly-, probably-, or definitely-related to study drug coded as CTCAE grades 3, 4, or 5.

Source: https://euclinicaltrials.eu/ctis-public/view/2023-506575-99-00